EU clinical trial 2023-503542-31-00: Effect of itraconazole on the pharmacokinetics of a single oral dose of BI 1584862 in healthy male subjects (an open-label, two-period, fixed-sequence design study)
Protocol code: 1484-0003
Sponsor: Boehringer Ingelheim International GmbH (Industry). Phase: Phase I and Phase II (Integrated)- Other. Countries: Germany (ended).
Therapeutic area(s): Not possible to specify
Gender: Male. Age: 18-64 years. Enrolment: 14.
Status: Ended. Start date (EU): 2023-09-29. End date (EU): 2023-11-10. Decision date: 2023-09-08. Results received: Yes. Last updated: 2023-09-08.

Condition(s): Healthy volunteer trial
Product: Sempera Liquid 10 mg/ml Lösung zum Einnehmen

Primary endpoint: AUC0-∞ (area under the concentration-time curve of the analyte in plasma over the time interval from 0 extrapolated to infinity), Cmax (maximum measured concentration of the analyte in plasma)
Endpoint(s): AUC0-tz (area under the concentration-time curve of the analyte in plasma over the time interval from 0 to the last quantifiable data point)

Source: https://euclinicaltrials.eu/ctis-public/view/2023-503542-31-00